EU clinical trial 2022-500689-87-00: Multicenter, Open-label, Phase 2, Extension Trial to Study the Long-term Safety in Participants With PROS or Proteus Syndrome Who Are Currently Being Treated with Miransertib in Other Studies
Protocol code: MK-7075-006
Sponsor: Merck Sharp & Dohme LLC (Pharmaceutical company). Phase: Therapeutic exploratory (Phase II). Countries: Italy (ongoing, recruitment ended).
Therapeutic area(s): Phenomena and Processes [G] - Genetic Phenomena [G05]
Gender: Female, Male. Age: 0-17 years, 18-64 years, 65+ years. Enrolment: 19.
Status: Ongoing, recruitment ended. Start date (EU): 2021-11-05. Decision date: 2022-06-28. Results received: No. Last updated: 2026-02-18.

Condition(s): PIK3CA-related overgrowth spectrum (PROS) and Proteus Syndrome (PS)
Product: MK-7075, MK-7075

Primary endpoint: Number of participants experiencing a Serious Adverse Event (SAE), Number of participants discontinuing study treatment due to an Adverse Event (AE)

Source: https://euclinicaltrials.eu/ctis-public/view/2022-500689-87-00